EU clinical trial 2024-516049-38-00: A Phase II, multi-center, prospective, open-label study of Asciminib in patients with Chronic Myeloid Leukemia in Chronic Phase (CML-CP) or accelerated Phase (CML-AP) with T315I mutation who are resistant, intolerant or ineligible to ponatinib (ASC4TARGET)
Protocol code: CABL001AFR05
Sponsor: Novartis Pharma S.A.S. (Pharmaceutical company). Phase: Therapeutic exploratory (Phase II). Countries: France (ongoing, recruiting).
Therapeutic area(s): Diseases [C] - Neoplasms [C04]
Gender: Female, Male. Age: 18-64 years, 65+ years. Enrolment: 20.
Status: Ongoing, recruiting. Start date (EU): 2025-02-18. Decision date: 2024-11-05. Results received: No. Last updated: 2026-04-30.

Condition(s): CML-CP or CML-AP patients with T315I mutation
Product: Scemblix 40 mg film-coated tablets

Primary endpoint: Rate of BCR::ABL1 IS ≤ 1% (MR2) at 12 months.
Endpoint(s): Kinetics of response: BCR::ABL1 IS (MR2, major molecular response (MMR), MR4.0, MR4.5, undetectable MR4.5) at and by 3, 6, 9, 12, 18 and 24 months for all patients,, Estimate response to treatment MR2 at 12 months in patients with BCR::ABL1 IS > 1% at treatment initiation or maintenance of MR2 at 12 months in patients with MR2 at treatment initiation,, Time to MMR (for patients not in MMR at treatment initiation),, Duration of MMR patient, Time to MR2 (for patients not in MR2 at treatment initiation),, Duration of MR2,, Overall survival (OS),, Progression Free Survival (PFS),, Event Free Survival (EFS),, Failure Free Survival (FFS)., Number of patients with an AE (frequency),, Description/severity (grade of severity) of AE (all AE, serious or not serious AE, related and not related AE), and number of patients who discontinued the treatment due to AE,, Deaths and reasons for death.

Source: https://euclinicaltrials.eu/ctis-public/view/2024-516049-38-00